EU clinical trial 2022-500777-14-00: A phase 2b, randomised, double-blind, placebo-controlled, multi-site, parallel-group, dose finding trial to evaluate the efficacy and safety of different doses of subcutaneously administered LEO 138559 in adult subjects with moderate-to-severe atopic dermatitis (AD)
Protocol code: LP0145-2240
Sponsor: Leo Pharma A/S (Pharmaceutical company). Phase: Therapeutic exploratory (Phase II). Countries: Romania (ended), Germany (ended), France (ended), Spain (ended), Hungary (ended), Czechia (ended), Poland (ended).
Therapeutic area(s): Diseases [C] - Skin and Connective Tissue Diseases [C17]
Gender: Female, Male. Age: 18-64 years, 65+ years. Enrolment: 153.
Status: Ended. Start date (EU): 2023-11-06. End date (EU): 2025-04-03. Decision date: 2023-10-11. Results received: Yes. Last updated: 2025-02-25.
Decision dates by country: ES: 2023-10-11, PL: 2023-10-16, FR: 2023-10-16, DE: 2023-10-12, HU: 2023-10-12, RO: 2023-10-16, CZ: 2023-10-12

Condition(s): Atopic Dermatitis
Product: LEO138559 solution for injection (150 mg/ml), Placebo

Primary endpoint: Percent change in EASI score from baseline to Week 16
Endpoint(s): Number of TEAEs recorded for each subject from baseline to Week 16.

Source: https://euclinicaltrials.eu/ctis-public/view/2022-500777-14-00